EU clinical trial 2023-507259-31-00: The effect of perineural botox on chronic cutaneous neuropathic pain
Sponsor: Aarhus Universitetshospital (Hospital/Clinic/Other health care facility). Phase: Therapeutic use (Phase IV). Countries: Denmark (ended).
Therapeutic area(s): Diseases [C] - Nervous System Diseases [C10]
Gender: Female, Male. Age: 18-64 years, 65+ years. Enrolment: 50.
Status: Ended. End date (EU): 2024-11-18. Decision date: 2023-10-16. Results received: Yes. Last updated: 2023-10-16.

Condition(s): Neuropathy
Product: Natriumklorid ”B. Braun”, BOTOX, pulver til injektionsvæske, opløsning 50 Allergan-enheder

Primary endpoint: The number of responders in the botox group versus the placebo group. Responders are defined as patients who at the 4 weeks follow-up, describe the pain-relieving effect in the neuropathic area(s) during the last 48 hours as mild, moderate or good.
Endpoint(s): Change in overall pain score (NRS) estimated during the last 48 hours at the time of the 4-week follow-up in botox versus placebo group, Change in pain score (NRS) at rest/activity/provocation in the neuropathic area(s) estimated during the last 48 hours at the time of the 4-week follow-up in botox versus placebo group, Time to onset of the pain-relieving effect of botox, where effect is defined as mild, moderate or good pain-relieving effect for at least 48 hours, Time to onset of maximal pain-relieving effect of botox, Change in overall maximal pain score (NRS) for botox responders, Number of patients in the botox group with maximal pain-relieving effect later than at the 4-week follow-up, Overall satisfaction (not satisfied/satisfied) with the treatment in the botox versus placebo group evaluated at the 4- week follow-up, Change in sleep quality (worse, unchanged, improved) in the botox versus placebo group evaluated at the 4-week follow-up, Change in activity level (lower, unchanged, higher) in the botox versus placebo group evaluated at the 4-week follow-up, "Patient global impression of change" in botox versus placebo groups evaluated at the time of 4-week-follow-up, Duration of pain relieving effect (number of days) after injection of botox estimated in botox responders., Number of patients in the botox group who would recommend the treatment to other patients, Number of patients in the botox group who would want to receive botox treatment again in the future, Adverse events estimated from the time og injection of trial medication until the end of the trial

Source: https://euclinicaltrials.eu/ctis-public/view/2023-507259-31-00